EU clinical trial 2024-511352-41-00: A study in patients with different types of advanced cancer (solid tumors) to test different doses of BI 907828 (brigimadlin) in combination with BI 754091 (ezabenlimab) and BI 754111 or BI 907828 (brigimadlin) in combination with BI 754091 (ezabenlimab)
Protocol code: 1403-0002
Sponsor: Boehringer Ingelheim International GmbH, Boehringer Ingelheim Espana S.A. (Pharmaceutical company). Phase: Human Pharmacology (Phase I)- Other. Countries: Netherlands (ended), Germany (ended), France (ended), Spain (ended), Hungary (ended), Belgium (ended).
Therapeutic area(s): Diseases [C] - Neoplasms [C04]
Gender: Female, Male. Age: 18-64 years, 65+ years. Enrolment: 53.
Status: Ended. Start date (EU): 2022-06-13. End date (EU): 2025-07-16. End date: 2026-02-06. Decision date: 2024-08-27. Results received: No. Last updated: 2025-06-05.
Decision dates by country: NL: 2024-08-27, BE: 2024-08-28, FR: 2024-09-10, DE: 2024-08-27, HU: 2024-08-27, ES: 2024-09-06

Condition(s): advanced solid tumors

Source: https://euclinicaltrials.eu/ctis-public/view/2024-511352-41-00